EU clinical trial 2024-519587-40-00: A Phase 1/2a Open-Label Ascending Dose Study to Evaluate the Safety and Effects of LY3884961 in Patients with Parkinson’s Disease with at Least One GBA1 Mutation (PROPEL)
Protocol code: J3Z-MC-OJAA
Sponsor: Prevail Therapeutics Inc. (Pharmaceutical company). Phase: Phase I and Phase II (Integrated)- First administration to humans. Countries: Netherlands (not authorised).
Therapeutic area(s): Diseases [C] - Nervous System Diseases [C10]
Gender: Female, Male. Age: 18-64 years, 65+ years. Enrolment: 5.
Status: Not authorised. Decision date: 2025-06-16. Results received: No. Last updated: 2025-06-16.

Condition(s): Parkinson’s Disease with at Least One GBA1 Mutation
Product: LY3884961

Primary endpoint: Incidence and severity of treatment-emergent AEs and SAE, Incidence of procedure or treatment-emergent safety findings, Treatment emergent and change from baseline in immunogenicity of adeno-associated viruses serotype 9 and glucocerebrosidase
Endpoint(s): Change from baseline in glycolipid and glucocerebrosidase levels, as well as glucocerebrosidase enzyme activity in blood, Change from baseline in glycolipid and glucocerebrosidase levels, as well as glucocerebrosidase enzyme activity in cerebrospinal fluid

Source: https://euclinicaltrials.eu/ctis-public/view/2024-519587-40-00